EU clinical trial 2023-505262-28-00: A Phase 1 Trial of the Menin Inhibitor Ziftomenib in Combination with Chemotherapy for Children with Relapsed/Refractory KMT2A-rearranged, NUP98-rearranged, or NPM1-mutant Acute Leukemia
Sponsor: Prinses Maxima Centrum voor Kinderoncologie B.V. (Hospital/Clinic/Other health care facility). Phase: Human Pharmacology (Phase I)- Other. Countries: France (ongoing, recruiting), Austria (ongoing, recruiting), Netherlands (ongoing, recruiting), Spain (ongoing, recruiting), Italy (ongoing, recruiting).
Therapeutic area(s): Diseases [C] - Hemic and Lymphatic Diseases [C15]
Gender: Female, Male. Age: 0-17 years, 18-64 years. Enrolment: 10.
Status: Ongoing, recruiting. Start date (EU): 2025-03-24. Decision date: 2024-11-25. Results received: No. Last updated: 2024-12-02.
Decision dates by country: AT: 2024-12-02, FR: 2024-11-27, IT: 2024-11-25, ES: 2024-12-02, NL: 2024-11-27

Condition(s): Acute Myeloid Leukemia, Mixed Phenotype Acute Leukemia, Acute Lymphocytic Leukemia
Product: Ziftomenib, Ziftomenib, Cytarabine 20 mg/ml Solution for Injection/Infusion, Fludarabine phosphate 25 mg/ml Concentrate for Solution for Injection or Infusion, Ziftomenib, Cytarabine 20 mg/ml Solution for Injection/Infusion, Solu-Cortef Powder for Solution for Injection or Infusion 100 mg

Primary endpoint: The primary endpoint is determination of the RP2D based on: Dose-limiting toxicities (DLTs) assessed during the first cycle of treatment.; Pharmacokinetic parameters of ziftomenib: AUC.
Endpoint(s): Adverse events (AEs), as characterized by type, frequency, severity (as graded using CTCAE version 5.0), timing, seriousness, and relation to study therapy., AEs, as characterized by type, frequency, severity (as graded using CTCAE version, v5.0), timing, seriousness, and relation to study therapy during prolonged exposure, AEs, as characterized by type, frequency, severity (as graded using CTCAE version, v5.0), timing, seriousness, and relation to study therapy post HSCT, PK of ziftomenib in combination with FLA chemotherapy: PK parameters of ziftomenib including Cmax, Cmin, Tmax, AUC0-t, AUC0-∞, CL/F, Vz/F, and t½, The rate of those proceeding to subsequent hematopoietic stem cell transplantation as consolidation therapy is calculated as the number of patients who receive a hematopoietic stem cell infusion divided by the total number of patients enrolled and started treatment., The following parameters will be studied: Morphological ORR, defined as CR plus CRp and CRi (defined in Section 11.2.1); Flow-based overall response rate (ORR, defined in Section 11.2.1); Flow-based Measurable Residual Disease (MRD) negativity rate; Duration of response (DOR); Event free survival (EFS): 1 year after EOT of the last patient with ziftomenib; Overall survival (OS): 1 year after EOT of the last patient with ziftomenib; Cumulative incidence of relapse (CIR): 1 year after EOT

Source: https://euclinicaltrials.eu/ctis-public/view/2023-505262-28-00